EU clinical trial 2024-510798-84-00: Hyperbaric oxygen treatment added to standard care for acute idiopathic sudden sensorineural hearing loss - a multicentre randomized controlled trial
Protocol code: SuDHO_1.0
Sponsor: Helse Bergen HF (Hospital/Clinic/Other health care facility). Phase: Phase II and Phase III (Integrated). Countries: Norway (ongoing, recruiting).
Therapeutic area(s): Diseases [C] - Otorhinolaryngologic Diseases [C09]
Gender: Female, Male. Age: 18-64 years, 65+ years. Enrolment: 490.
Status: Ongoing, recruiting. Start date (EU): 2022-01-28. Decision date: 2024-10-13. Results received: No. Last updated: 2025-05-23.

Condition(s): Idiopathic sudden sensorineural hearing loss (ISSNHL)
Product: OXYGEN

Primary endpoint: Mean absolute pure tone average (PTA*) at week 14 *PTA=mean hearing-threshold in dB of the 4 frequencies 0,5 kHz, 1kHz, 2kHz and 4kHz
Endpoint(s): Mean change in PTA (dB) from baseline to week 14, Proportion of patients with improvement of at least 10dB PTA from baseline to week 14, Mean word recognition score (WRS) in percentage-points at week 14 and change from baseline, Categories of hearing recovery according to Siegel's criteria at week 14, Categories of hearing-loss severity and proportion of patients with serviceable hearing according to the AAO-HNS criteria at baseline and week 14, Total score of patient reported communication problems assessed by APHAB-questionnaire at day 1 and week 14, RAND-12 scores at day 1 and week 14, Adverse events (AE) and serious AEs (SAE), Known side-effects of HBOT, Mean APHAB score at week 14

Source: https://euclinicaltrials.eu/ctis-public/view/2024-510798-84-00